EU clinical trial 2024-514609-76-00: SIRIUS Sarcoidosis with moderate to severe facial skin involvement: an open multicenter study of the efficacy and safety of oral sirolimus
Sponsor: Assistance Publique Hopitaux De Paris (Hospital/Clinic/Other health care facility). Phase: Therapeutic exploratory (Phase II). Countries: France (ongoing, recruitment ended).
Therapeutic area(s): Diseases [C] - Immune System Diseases [C20]
Gender: Female, Male. Age: 18-64 years, 65+ years. Enrolment: 10.
Status: Ongoing, recruitment ended. Start date (EU): 2022-11-23. Decision date: 2024-08-08. Results received: No. Last updated: 2026-04-30.

Condition(s): Adult patients (men and women) (≥ 18 years of age) with cutaneous sarcoidosis involving the face
Product: SIROLIMUS

Primary endpoint: percentage of patients with a significant clinical response (relative decrease in SASI facial ≥ 25%) at 16 weeks of treatment
Endpoint(s): 1- Percentage of patients with a significant clinical response (relative reduction in facial SASI ≥ 50%) at 16 weeks of treatment, 2- Percentage of patients with a complete clinical response ("SASI facial" = 0) at 16 weeks of treatment (SASI facial clinical assessment at screening, inclusion and closing visit (S16)), 2'- Percentage of patients with a complete or near-complete response according to skin PGA (PGA = 0 or 1)., 3- Percentage of patients with improved dermatological quality of life (DLQI reduction > 25%) after 16 weeks of treatment (DLQI in appendix 2)., parison of front and profile photographs of the face with good luminosity between S0 and S16 (macroscopic assessment by the clinician)., 5- Sarcoidosis activity score assessed for all organs by ePOST (extra-pulmonary organ severity score from 0 to 6) + SDAI score at S16 or at study discharge (compared with inclusion), 5'- Pulmonary sarcoidosis activity assessed by thoracic CT lung involvement (aCTAS score) at S16 or at study discharge, 5''- Functional evaluation of pulmonary sarcoidosis assessed by respiratory function tests (vital capacity and gait perimeter) at S16 or at study discharge., 6- Collection of adverse events up to S16, in particular: mouth ulcers, drop in hemoglobin, leukocytes, platelets, infections, etc., 7- Evaluate CD68, phospho-mTOR and phospho-p70S6K labeling on skin biopsies and expression of coding mRNA transcripts by microarray (Affymetrix) in skin and circulating monocytes.

Source: https://euclinicaltrials.eu/ctis-public/view/2024-514609-76-00